EU clinical trial 2024-520317-49-02: Intraperitoneal treatment with fosfomycin, metronidazole and recombinant human granulocyte-macrophage colony-stimulating factor in patients with multi-quadrant peritonitis undergoing abdominal surgery: A randomized placebo-controlled trial (TRIPLE)
Protocol code: 2025-GMF-1
Sponsor: Region Sjaelland, Reponex Pharmaceuticals A/S (Hospital/Clinic/Other health care facility, Pharmaceutical company). Phase: Human Pharmacology (Phase I)- Other. Countries: Denmark (authorised, recruitment pending).
Therapeutic area(s): Diseases [C] - Digestive System Diseases [C06]
Gender: Female, Male. Age: 18-64 years, 65+ years. Enrolment: 32.
Status: Authorised, recruitment pending. Decision date: 2025-08-22. Results received: No. Last updated: 2026-03-19.
Decision dates by country: DK: 2025-08-29

Condition(s): peritonitis
Product: Repomol, Metronidazol ”Baxter” Viaflo, infusionsvæske, opløsning, Saline Solution Basi 9 mg/ml solution for infusion, Fosfomycin "Infectopharm", pulver til infusionsvæske, opløsning 40 mg/ml

Primary endpoint: Clinical failure at POD28 (composite outcome: either death, surgical site wound infection, unplanned surgery or drainage due to complication or recurrence of intraabdominal infection or initiation of non-trial antibiotics due to worsening of intraabdominal infection)
Endpoint(s): Macrophage phagocytosis assay on PBMCs, Change in cytokine levels in peripheral blood, Change in various blood values: • Hematology, • K+, • Na+, • CRP, • Albumin, • Creatinine (incl. eGFR), Quality of recovery-15, Postoperative complications according to Clavien-Dindo, Length of hospital stay, length of intensive care unit stay, Duration of intravenous antibiotics treatment

Source: https://euclinicaltrials.eu/ctis-public/view/2024-520317-49-02